EU clinical trial 2023-508572-11-00: Systemic Targeted Adaptive RadioTherapy of NeuroEndocrine Tumors. An open-label, multi-center, randomized phase III trial comparing safety and efficacy of personalized vs non-personalized radionuclide therapy with 177Lu-DOTATOC
Sponsor: Region Skane (Hospital/Clinic/Other health care facility). Phase: Therapeutic confirmatory (Phase III). Countries: Sweden (ongoing, recruiting).
Therapeutic area(s): Diseases [C] - Neoplasms [C04]
Gender: Female, Male. Age: 18-64 years, 65+ years. Enrolment: 300.
Status: Ongoing, recruiting. Start date (EU): 2022-06-21. Decision date: 2024-10-15. Results received: No. Last updated: 2026-04-14.

Condition(s): neuroendocrine tumours
Product: 177Lu-Edotreotide, CAPECITABINE

Primary endpoint: Median PFS defined as time from randomization to radiological progression, or death from any cause
Endpoint(s): Rate of treatment-related adverse reactions graded according to CTCAE v5.0, Median OS defined as time from randomization to death from any cause, Median PFS defined as time from randomization to radiological progression, or death from any cause, Percent change in SLD from baseline to time of best response, EORTC QoL-questionnaires GI-NET21, Cumulative median AD to target tumor lesions in subjects with CR, PR, SD and PD as best response, according to RECIST evaluations, Correlation between cumulative median AD to target tumor lesions and time to progression, defined as time from randomization to radiological progression., Cumulative median AD and BED to kidneys vs rate of grade 3-4 renal toxicity (estimated and measured GFR), Differences in resource utilization and treatment cost between the two treatment arms, in relation to the respective mPFS and mOS.

Source: https://euclinicaltrials.eu/ctis-public/view/2023-508572-11-00